EU clinical trial 2024-512021-81-00: Phase II clinical trial to assess the efficacy of dostarlimab as neoadjuvant therapy in patients with MMRd/MSI-H stage II-III endometrial cancer
Protocol code: GEICO 137-E
Sponsor: Grupo Espanol De Investigacion En Cancer De Ovario (Patient organisation/association). Phase: Therapeutic exploratory (Phase II). Countries: Spain (ongoing, recruiting).
Therapeutic area(s): Diseases [C] - Neoplasms [C04]
Gender: Female. Age: 18-64 years, 65+ years. Enrolment: 25.
Status: Ongoing, recruiting. Start date (EU): 2025-12-01. Decision date: 2025-08-06. Results received: No. Last updated: 2025-08-18.

Condition(s): MMRd/MSI-H stage II-III endometrial cancer
Product: JEMPERLI 500 mg concentrate for solution for infusion

Primary endpoint: cCR: Efficacy measured by the proportion of patients who did not undergo surgery due to cCR after neoadjuvant dostarlimab. cCR is defined as the absence of tumor persistence evaluated by MRI, CT, PET scan, pelvic exam, and review of surgical specimen.
Endpoint(s): pCR: Efficacy measured by the proportion of patients who had pCR having undergone surgery after neoadjuvant dostarlimab. pCR is defined as the absence of invasive tumor in the surgical specimen by local pathology review., ORR: Efficacy measured by ORR, which is defined as the number of patients with a best overall response (BOR) of complete response (CR) or partial response (PR) divided by the number of response evaluable patients (according to RECIST v1.1)., DFS: Efficacy measured by DFS, which is defined as the time in months from date of enrollment to date of local or distant recurrence (assessed radiologically by the investigator or by histopathologic confirmation), or death due to any cause, whichever occurs first., mOS: Efficacy measured by mOS, which is defined as the median of time in months from date of enrollment to date of death due to any cause. OS will be censored on the last date a patient was known to be alive., Toxicity will be assessed by adverse events related to study drugs, detected through physical examinations and laboratory tests, and graded according to CTCAE v5.0.

Source: https://euclinicaltrials.eu/ctis-public/view/2024-512021-81-00